EU clinical trial 2025-520617-31-00: An open label, balanced, randomized, two-treatment, four-period, two-sequence, single-dose, crossover fully replicate bioequivalence study comparing Mesalamine delayed release capsules 400 mg manufactured by Sun Pharmaceutical Industries Limited, India with Mesalamine Delayed-Release Capsules 400 mg, manufactured for Teva Pharmaceuticals USA, Inc. Parsippany, NJ 07054, in healthy, adult, human subjects under fasting condition.
Protocol code: MESAL-19-24
Sponsor: Sun Pharmaceutical Industries Limited (Pharmaceutical company). Phase: Human Pharmacology (Phase I)- Bioequivalence Study. Countries: Romania (ongoing, recruitment ended).
Therapeutic area(s): Diseases [C] - Digestive System Diseases [C06]
Gender: Female, Male. Age: 18-64 years. Enrolment: 112.
Status: Ongoing, recruitment ended. Start date (EU): 2025-09-12. Decision date: 2025-06-25. Results received: No. Last updated: 2025-06-25.

Condition(s): ulcerative colitis

Source: https://euclinicaltrials.eu/ctis-public/view/2025-520617-31-00